EU clinical trial 2024-519564-41-00: Measuring the levels of LSD in the human brain using neuroimaging
Protocol code: H-21060056
Sponsor: Rigshospitalet (Hospital/Clinic/Other health care facility). Phase: Human Pharmacology (Phase I)- Other. Countries: Denmark (ongoing, recruiting).
Therapeutic area(s): Not possible to specify
Gender: Female, Male. Age: 18-64 years, 65+ years. Enrolment: 38.
Status: Ongoing, recruiting. Start date (EU): 2025-01-22. Decision date: 2025-01-22. Results received: No. Last updated: 2026-06-17.

Condition(s): No medical condition will be examined.

Source: https://euclinicaltrials.eu/ctis-public/view/2024-519564-41-00